EU clinical trial 2024-514339-87-00: A study to investigate VMX-C001 in healthy volunteers.
Protocol code: VMX-C001-02
Sponsor: VarmX B.V. (Pharmaceutical company). Phase: Human Pharmacology (Phase I)- Other. Countries: Netherlands (ended).
Therapeutic area(s): Phenomena and Processes [G] - Circulatory and Respiratory Physiological Phenomena [G09]
Gender: Female, Male. Age: 18-64 years. Enrolment: 12.
Status: Ended. Start date (EU): 2024-08-14. End date (EU): 2026-04-13. Decision date: 2024-05-29. Results received: No. Last updated: 2026-02-03.

Condition(s): To restore coagulation in patients taking DOACs who are experiencing bleeding or who require reversal of anticoagulation prior to urgent surgery.

Source: https://euclinicaltrials.eu/ctis-public/view/2024-514339-87-00